EU clinical trial 2023-509675-16-01: Reduced anticoagulation targets in extracorporeal life support
Sponsor: Universitair Medisch Centrum Groningen (Hospital/Clinic/Other health care facility). Phase: Therapeutic confirmatory (Phase III). Countries: Netherlands (authorised, recruitment pending).
Therapeutic area(s): Diseases [C] - Respiratory Tract Diseases [C08]; Diseases [C] - Cardiovascular Diseases [C14]
Gender: Female, Male. Age: 18-64 years, 65+ years. Enrolment: 330.
Status: Authorised, recruitment pending. Decision date: 2025-01-28. Results received: No. Last updated: 2025-01-28.

Condition(s): All patients who receive ECMO treatment during the study period in one the participating centers from which (deferred) informed consent is obtained. Patients in whom the ECMO is only used to bridge a procedure like a high risk percutaneous coronary intervention or during surgery are excluded.
Product: HEPARIN, NADROPARIN

Primary endpoint: The primary outcome parameter is a combined endpoint consisting of: 1) major bleeding including hemorrhagic stroke according to the ELSO definitions; 2) severe thromboembolic complication defined as ischemic stroke, limb ischemia (not related with distal perfusion catheter), or acute pump failure with emergency exchange; 3) mortality at 6 months.
Endpoint(s): Secondary outcome parameters are: 1) blood transfusions; 2) health related quality of life (HR-QoL) at 6 months; 3) exchange of the membrane oxygenator; 4) vessel thrombosis after ECMO removal detected by echography; 5) pulmonary embolism; 6) costs; 7) the individual components of the composite outcome; and 8) all thromboembolic complications combined.

Source: https://euclinicaltrials.eu/ctis-public/view/2023-509675-16-01